EU clinical trial 2025-522482-30-00: Double-blind, Placebo-Controlled, Randomized Exploratory Trial: Topical VDA-1102 Ointment in Rapidly Proliferating Actinic Keratosis
Protocol code: VDA-CP-06 P2B
Sponsor: Vidac Pharma Ltd. (Pharmaceutical company). Phase: Therapeutic exploratory (Phase II). Countries: Germany (ongoing, recruitment ended).
Therapeutic area(s): Diseases [C] - Skin and Connective Tissue Diseases [C17]
Gender: Female, Male. Age: 18-64 years, 65+ years. Enrolment: 39.
Status: Ongoing, recruitment ended. Start date (EU): 2026-02-11. Decision date: 2025-11-03. Results received: No. Last updated: 2025-11-03.

Condition(s): Actinic keratosis
Product: VDA-1102, VDA-1102 placebo

Primary endpoint: The modified PRO score of the marker lesion assessed by LC-OCT after a treatment period of 12 weeks will serve as primary endpoint. The marker lesion will be defined as the AK lesion with the highest PRO score (basal proliferation score as assessed by LC-OCT prior to treatment start) on head or face of the study participant at study entry
Endpoint(s): 1. Secondary efficacy endpoints: The clearance of budding (PRO II) and papillary sprouting (PRO III) of the marker lesion assessed by LC-OCT at week 12., Histological assessment of the modified PRO score of the marker lesion after a treatment period of 12 weeks based on a biopsy (optional)., Number of visible or palpable AK lesions in the treatment area., Complete clearance rate assessed by lesion count with complete clearance being defined as the complete disappearance of all visible or palpable AK lesions in the treatment area., Partial clearance rate 75%. A partial clearance 75% is achieved if the number of clinically visible or palpable AK lesions in the treatment area is reduced by at least 75% but less than 100% compared with baseline, Assessment of cosmetic appearance after 12 weeks in comparison to Visit 1., Study participants’ assessment of the test product in comparison to placebo at the end of treatment., 2. Secondary safety endpoints: (Serious) adverse events., Local Skin Reaction Scores., Number of histologically confirmed squamous cell carcinoma (SCC) in the treatment area.

Source: https://euclinicaltrials.eu/ctis-public/view/2025-522482-30-00